EU clinical trial 2025-523015-11-00: Bisoprolol for pericarditis -Phase III randomized controlled clinical trial in patients with acute or recurrent pericarditis
Protocol code: BIP
Sponsor: Azienda Sanitaria Universitaria Friuli Centrale (Hospital/Clinic/Other health care facility). Phase: Therapeutic confirmatory (Phase III). Countries: Italy (ongoing, recruiting).
Therapeutic area(s): Diseases [C] - Cardiovascular Diseases [C14]
Gender: Female, Male. Age: 18-64 years, 65+ years. Enrolment: 300.
Status: Ongoing, recruiting. Start date (EU): 2026-03-18. Decision date: 2025-10-27. Results received: No. Last updated: 2026-02-17.

Condition(s): Pericarditis
Product: BISOPROLOL

Primary endpoint: The aim of this study is to evaluate the effectiveness of beta-blocking therapy with bisoprolol in reduce the persistence of pericarditis symptoms at 2 and 4 weeks and the frequency of relapses at 12 months
Endpoint(s): Secondary endpoints: persistence of symptoms at 1 month. Frequency of relapses at 12 months. Additional secondary analysis: correlation between baseline C-reactive protein values and heart rate at first observation

Source: https://euclinicaltrials.eu/ctis-public/view/2025-523015-11-00